EU clinical trial 2023-503440-14-00: A Multi-arm Phase 1b Study of Teclistamab With Other Anticancer Therapies in Participants With Multiple Myeloma
Sponsor: Janssen - Cilag International (Pharmaceutical company). Phase: Human Pharmacology (Phase I)- Other. Countries: Belgium (ongoing, recruitment ended), France (ongoing, recruitment ended).
Therapeutic area(s): Diseases [C] - Hemic and Lymphatic Diseases [C15]
Gender: Female, Male. Age: 18-64 years, 65+ years. Enrolment: 43.
Status: Ongoing, recruitment ended. Start date (EU): 2021-03-08. Decision date: 2024-06-21. Results received: No. Last updated: 2026-02-05.
Decision dates by country: BE: 2024-06-25, FR: 2024-06-21

Condition(s): Relapsed/Refractory Multiple Myeloma

Source: https://euclinicaltrials.eu/ctis-public/view/2023-503440-14-00